EU clinical trial 2024-513036-26-00: A Multicenter, Randomized, Double-blind, Placebo-controlled Study to Assess the Efficacy and Safety of Lumateperone in the Acute Treatment of Patients with Manic Episodes or Manic Episodes with Mixed Features Associated with Bipolar I Disorder (Bipolar Mania)
Protocol code: ITI-007-451
Sponsor: Intra-Cellular Therapies Inc. (Pharmaceutical company). Phase: Therapeutic confirmatory (Phase III). Countries: Croatia (ended), Bulgaria (ended).
Therapeutic area(s): Psychiatry and Psychology [F] - Mental Disorders [F03]
Gender: Female, Male. Age: 18-64 years, 65+ years. Enrolment: 80.
Status: Ended. Start date (EU): 2024-12-20. End date (EU): 2026-01-22. End date: 2026-03-05. Decision date: 2024-11-20. Results received: No. Last updated: 2026-05-07.
Decision dates by country: BG: 2024-11-20, HR: 2024-11-20

Condition(s): Bipolar I Disorder (Bipolar Mania)
Product: Placebo capsules (not containing the active substance, otherwise identical to lumateperone capsules)

Primary endpoint: Change from baseline to end of Week 3 in YMRS total score
Endpoint(s): Change from baseline to end of Week 3 in CGI-S score

Source: https://euclinicaltrials.eu/ctis-public/view/2024-513036-26-00